EU clinical trial 2023-503708-10-00: An Open Label, Randomized, Multicenter Study Comparing the Efficacy and Safety of the Combination of Lasofoxifene and Abemaciclib to the Combination of Fulvestrant and Abemaciclib for the Treatment of Pre- and Postmenopausal Women and Men with Locally Advanced or Metastatic ER+/HER2− Breast Cancer with an ESR1 Mutation
Protocol code: SMX 22-002
Sponsor: Leonabio Inc. (Pharmaceutical company). Phase: Therapeutic confirmatory (Phase III). Countries: France (ongoing, recruiting), Spain (ongoing, recruiting), Romania (ongoing, recruiting), Hungary (ended), Poland (ongoing, recruiting), Italy (ongoing, recruiting), Belgium (ongoing, recruiting), Germany (authorised, recruitment pending).
Therapeutic area(s): Diseases [C] - Neoplasms [C04]
Gender: Female, Male. Age: 18-64 years, 65+ years. Enrolment: 290.
Start date (EU): 2024-02-20. Decision date: 2023-11-28. Results received: No. Last updated: 2026-07-09.
Decision dates by country: FR: 2023-11-29, HU: 2023-12-01, ES: 2023-11-28, BE: 2024-03-26, RO: 2023-12-04, IT: 2023-12-01, DE: 2024-03-07, PL: 2023-12-01

Condition(s): Locally advanced or metastatic breast cancer
Product: Abemaciclib, Lasofoxifene, Fulvestrant

Primary endpoint: Progression free survival (PFS) is defined as the time from the date of randomization [expected at Visit 0 (Day 1)] to the earliest date of first documented disease progression or death due to any cause.
Endpoint(s): Objective response rate (ORR) is defined as the percentage of subjects with measurable disease at baseline whose best overall response post-randomization is either a confirmed CR or a confirmed PR according to RECIST 1.1., Overall Survival (OS) is defined as time from the date of randomization [expected at Visit 0 (Day 1)] to death due to any cause

Source: https://euclinicaltrials.eu/ctis-public/view/2023-503708-10-00